EU clinical trial 2023-508981-13-00: A Randomized, Multiple-Dose, Open-Label, Parallel-Group Study to Evaluate the Pharmacokinetic Profiles of LY03010 and the Relative Bioavailability at Steady-State of LY03010 versus XEPLION® in Patients with Schizophrenia
Protocol code: LY03010/CT-EUR-102
Sponsor: Geneora Pharma (Shijiazhuang) Co. Ltd. (Pharmaceutical company). Phase: Human Pharmacology (Phase I)- Bioequivalence Study. Countries: Bulgaria (authorised, recruitment pending), Croatia (authorised, recruitment pending), Portugal (authorised, recruitment pending).
Therapeutic area(s): Psychiatry and Psychology [F] - Mental Disorders [F03]
Gender: Female, Male. Age: 18-64 years, 65+ years. Enrolment: 170.
Status: Authorised, recruitment pending. Decision date: 2024-04-04. Results received: No. Last updated: 2024-08-27.
Decision dates by country: BG: 2024-04-08, PT: 2024-04-05, HR: 2024-04-04

Condition(s): Schizophrenia

Source: https://euclinicaltrials.eu/ctis-public/view/2023-508981-13-00